EU clinical trial 2023-504508-26-00: A Phase IV Open-Label Study Evaluating the Effectiveness and Safety of Risdiplam Administered as an Early Intervention in Pediatric Patients with Spinal Muscular Atrophy After Gene Therapy
Protocol code: BN44620
Sponsor: F. Hoffmann-La Roche AG (Pharmaceutical company). Phase: Therapeutic use (Phase IV). Countries: Germany (ongoing, recruiting), Poland (ongoing, recruiting).
Therapeutic area(s): Diseases [C] - Musculoskeletal Diseases [C05]
Gender: Female, Male. Age: 0-17 years. Enrolment: 15.
Status: Ongoing, recruiting. Start date (EU): 2024-11-14. Decision date: 2024-02-08. Results received: No. Last updated: 2026-03-20.
Decision dates by country: PL: 2024-02-09, DE: 2024-02-08

Condition(s): Spinal Muscular Atrophy (SMA)
Product: RO7034067, Evrysdi 0.75 mg/mL powder for oral solution

Primary endpoint: 1.Change from baseline in the raw score of Bayley Scales of Infant and Toddler DevelopmentTM, Third Edition (BSID-III) Gross Motor Score at 72 weeks of risdiplam treatment in this population of SMA patients
Endpoint(s): Incidence and severity of adverse events, with severity determined according to the NCI CTCAE v5.0, Incidence and severity of serious adverse events, Incidence of treatment discontinuation due to adverse events

Source: https://euclinicaltrials.eu/ctis-public/view/2023-504508-26-00